EU clinical trial 2024-519568-42-00: Cannabis extrAct in oncology Patients for the treatment of TUmor Related symptom burden (CAPTURE)
Protocol code: CAPTURE
Sponsor: IRCCS Istituto Nazionale Tumori Fondazione Pascale (Hospital/Clinic/Other health care facility). Phase: Therapeutic exploratory (Phase II). Countries: Italy (authorised, recruitment pending).
Therapeutic area(s): Diseases [C] - Neoplasms [C04]
Gender: Female, Male. Age: 18-64 years, 65+ years. Enrolment: 156.
Status: Authorised, recruitment pending. Decision date: 2025-08-21. Results received: No. Last updated: 2026-01-16.

Condition(s): Patients with advanced oncologic disease receiving active treatment with WHO level II or III opioids and adjuvants therapies
Product: Description and Composition of the Placebo; • Placebo oil solution matching the Cannabis Extract Avextra 10/10 Solution. • Pharmaceutical form: solution (oil); • Route of administration: oral; • Storage: Store tightly closed below 25°C and protected from light like the verum form. • Country of origin: Italy., Cannabis Extract Avextra 10/10 Solution

Primary endpoint: ESAS-TSDS, defined as the total score derived from the sum of individual ratings for each of the nine symptoms included in the ESAS questionnaire.
Endpoint(s): 1. NRS-2002 (Nutrition Risk Screening) score 2. Global Pittsburgh Sleep Quality Index (PSQI) score, reported as both the proportion of patients with sleep disturbances and the median total score 3. Douleur Neuropathique 4 (DN4) questionnaire score, reported as the proportion of patients with neuropathic pain and the median total score 4. Brief Fatigue Inventory (BFI) score 5. ESAS subscores at 8 weeks 6.Proportion of responders based on ESAS-TSDS at 8 weeks 7.Proportion of patients requiring

Source: https://euclinicaltrials.eu/ctis-public/view/2024-519568-42-00